EU clinical trial 2023-506913-23-00: Phase I-IIa, randomized, controlled, open-label, single-center clinical trial to evaluate the safety, feasibility, and evidence of efficacy of the use of an autologous tissue-engineered nanostructured fibrin-agarose oral mucosa substitute for human palatal mucosa in the treatment of patients with cleft palate
Protocol code: FIB-BIO-2023-03
Sponsor: Fundacion Publica Para La Investigacion Biosanitaria De Andalucia Oriental Alejandro Otero (Patient organisation/association). Phase: Phase I and Phase II (Integrated)- First administration to humans. Countries: Spain (temporarily halted).
Therapeutic area(s): Diseases [C] - Congenital, Hereditary, and Neonatal Diseases and Abnormalities [C16]
Gender: Female, Male. Age: 0-17 years. Enrolment: 15.
Status: Temporarily halted. Start date (EU): 2024-04-17. Decision date: 2023-11-21. Results received: No. Last updated: 2026-02-18.

Condition(s): Cleft lip and palate
Product: Autologous oral mucosa differentiated adult keratinocytes and fibroblasts|expanded in biological fibrin-agarose matrix

Primary endpoint: Feasibility: if in at least 3 of the 5 patients in the initial phase it can be verified that the surgical implantation of the BIOCLEFT has been carried out satisfactorily; Safety: occurrence of any adverse event, serious or non-serious, and specifically, those adverse events and serious adverse events related to treatment and indications of efficacy regeneration and healing; aesthetic appearance; craniofacial growth; hearing evaluation; speech therapist and quality of life

Source: https://euclinicaltrials.eu/ctis-public/view/2023-506913-23-00